EU clinical trial 2024-520160-34-00: PROSPECTIVE, PHASE II STUDY TO EVALUATE THE EFFICACY OF ADDITION OF PROGESTERONE TO STANDARD CHEMOTHERAPY ACCORDING TO EDP SCHEME PLUS MITOTANE IN PATIENTS WITH ADVANCED ADRENAL CORTICAL CARCINOMA - PESETA TRIAL
Sponsor: Azienda Socio Sanitaria Territoriale Degli Spedali Civili Di Brescia (Hospital/Clinic/Other health care facility). Phase: Therapeutic exploratory (Phase II). Countries: Italy (authorised, recruitment pending).
Therapeutic area(s): Diseases [C] - Neoplasms [C04]
Gender: Female, Male. Age: 18-64 years, 65+ years. Enrolment: 80.
Status: Authorised, recruitment pending. Decision date: 2025-01-31. Results received: No. Last updated: 2026-07-03.

Condition(s): Adrenocortical carcinoma
Product: ETOPOSIDE, DOXORUBICIN, CISPLATIN, The placebo prepared for the study consists in oval shaped biconvexed tablets that are scored on one side an engraved with "160" on the other side., MITOTANE, MEGACE 160 mg compresse

Primary endpoint: Comparison of proportion of patients attaining an Objective Response (Objective Response Rate, ORR), evaluated by RECIST criteria [29] between the 2 treatment arms.

Source: https://euclinicaltrials.eu/ctis-public/view/2024-520160-34-00